EU clinical trial 2024-512258-91-00: A Phase 3, Multi-center, Randomized, Quadruple-blind, Placebo-controlled Study to Assess the Efficacy and Safety of Batoclimab as Induction and Maintenance Therapy in Adult Participants with Generalized Myasthenia Gravis (gMG)
Protocol code: IMVT-1401-3101
Sponsor: Immunovant Sciences GmbH (Pharmaceutical company). Phase: Therapeutic confirmatory (Phase III). Countries: Romania (ended), Germany (ended), Italy (ended), Poland (ended), Spain (ended), Hungary (ended).
Therapeutic area(s): Diseases [C] - Nervous System Diseases [C10]
Gender: Female, Male. Age: 18-64 years, 65+ years. Enrolment: 152.
Status: Ended. Start date (EU): 2023-02-03. End date (EU): 2026-04-20. End date: 2026-04-21. Decision date: 2024-07-08. Results received: No. Last updated: 2026-06-05.
Decision dates by country: PL: 2024-07-24, HU: 2024-07-08, RO: 2024-07-09, DE: 2024-07-10, ES: 2024-07-15, IT: 2024-07-15

Condition(s): Generalized Myasthenia Gravis (gMG)
Product: Placebo is identical to IMP but with no active substance., Batoclimab

Primary endpoint: Change from Period 1 baseline in MG-ADL score to Week 12 for AChRAb+ participants (Timeframe: Period 1 baseline to Week 12).
Endpoint(s): Change from Period 1 baseline in QMG score to Week 12 for AChRAb+ participants (Timeframe: Period 1 baseline to Week 12)., Change from Period 2 baseline in MG-ADL score to Week 24 for AChRAb+ randomized withdrawal participants (Timeframe: Week 12 to Week 24)., Proportion of AChRAb+ participants with ≥ 3-point improvement (decrease in score) in QMG from Period 1 baseline to Week 12 (Timeframe: Period 1 baseline to Week 12)., Proportion of AChRAb+ participants achieving MG-ADL score of 0 or 1 by Week 12 (Timeframe: Period 1 baseline to Week 12)., Change from Period 1 baseline in MG-ADL score to Week 12 for AChRAb- participants (Timeframe: Period 1 baseline to Week 12).

Source: https://euclinicaltrials.eu/ctis-public/view/2024-512258-91-00